EU clinical trial 2024-519776-20-00: An open label, balanced, randomized, two-treatment, two-period, two-sequence, single-dose, crossover, bioequivalence study comparing Naltrexone hydrochloride film-coated tablet, 50 mg, manufactured by Sun Pharmaceutical Industries Limited, India with NALTREXONE GH (naltrexone hydrochloride) film-coated tablets 50 mg, Product of Generic Health Pty Ltd Suite 2, Level 2 19-23 Prospect Street Box Hill, VIC, 3128, Australia, in healthy adult, human subjects under fasting condition.
Protocol code: NALTR-17-24
Sponsor: Sun Pharmaceutical Industries Limited (Pharmaceutical company). Phase: Human Pharmacology (Phase I)- Bioequivalence Study. Countries: Romania (ended).
Therapeutic area(s): Psychiatry and Psychology [F] - Behavioral Disciplines and Activities [F04]
Gender: Female, Male. Age: 18-64 years. Enrolment: 72.
Status: Ended. Start date (EU): 2025-05-12. End date (EU): 2025-06-13. Decision date: 2025-04-28. Results received: No. Last updated: 2025-04-28.

Condition(s): Alcohol dependence

Source: https://euclinicaltrials.eu/ctis-public/view/2024-519776-20-00